EU clinical trial 2025-520535-16-00: A multicenter, open, prospective, randomized, parallel-group, 12-month trial of REduced immunosuppression for oLdEr AdultS kidnEy transplant recipients: the RELEASE study.
Protocol code: RELEASE
Sponsor: Consorci Mar Parc De Salut De Barcelona (Hospital/Clinic/Other health care facility). Phase: Therapeutic use (Phase IV). Countries: Spain (ongoing, recruiting).
Therapeutic area(s): Diseases [C] - Immune System Diseases [C20]
Gender: Female, Male. Age: 65+ years. Enrolment: 270.
Status: Ongoing, recruiting. Start date (EU): 2025-10-10. Decision date: 2025-07-16. Results received: No. Last updated: 2026-05-19.

Condition(s): End-stage renal disease
Product: BASILIXIMAB, METHYLPREDNISOLONE, MYCOPHENOLATE SODIUM, TACROLIMUS, MYCOPHENOLATE SODIUM, PREDNISONE

Primary endpoint: Composite outcome of patient survival with functioning graft at 12 months in both treatment arms.
Endpoint(s): Mortality for any reason in both treatment arms., Rate of primary non-function graft in both treatment arms., Incidence of surgical complications in both treatment arms., Days of hospitalization for any reason in both treatment arms., Number of readmissions and cause in both treatment arms., Incidence of CMV and BK viremia in both treatment arms., Incidence of CMV invasive disease and BK nephropathy in both treatment arms., Incidence of clinical graft acute rejection through indication biopsy at any time in both treatment arms., Incidence of subclinical graft rejection at 12 months through protocol biopsy in both treatment arms., PREM and PROMS at randomization and at 12 months in both treatment arms., Frailty (Fried and FRAIL scale) before transplant and at 12 months in both treatment arms., Death-censored graft survival in both treatment arms., Graft function (eGFR and proteinuria) at 12 months in both treatment arms., Donor-specific antibodies (DSA) at 12 months in both treatment arms., Estimated 5-y death-censored graft survival through the iBox prognostication system at 12 months in both treatment arms., Rate of dropout from the initial immunosuppression scheme assigned in both treatment arms., Exploratory: Torquetenovirus RT-PCR at 1, 3, 6 and 12 months in both treatment arms., Exploratory: Count of CD4/CD8 lymphocyte subpopulations, C3 levels, and IgG levels at 1, 3, and 12 months in both treatment arms.

Source: https://euclinicaltrials.eu/ctis-public/view/2025-520535-16-00